EU clinical trial 2023-503688-41-00: Efficacy of Vitex agnus-castus BNO 1095 (20 mg) in women with primary dysmenorrhea
Protocol code: AgnoMed
Sponsor: Bionorica SE (Pharmaceutical company). Phase: Therapeutic confirmatory (Phase III). Countries: Sweden (ended), Austria (ended), Poland (ended), Czechia (ended), Hungary (ended), Germany (ended).
Therapeutic area(s): Diseases [C] - Female Urogenital Diseases and Pregnancy Complications [C13]
Gender: Female. Age: 18-64 years. Enrolment: 300.
Status: Ended. Start date (EU): 2023-11-28. End date (EU): 2025-07-23. Decision date: 2023-11-20. Results received: Yes. Last updated: 2025-05-19.
Decision dates by country: AT: 2023-11-20, HU: 2023-11-22, PL: 2023-11-22, CZ: 2023-11-24, SE: 2023-11-20, DE: 2023-11-27

Condition(s): Primary Dysmenorrhea
Product: Placebo, DRY EXTRACT FROM CHASTE TREE FRUITS (7-11:1), EXTRACTION SOLVENT: ETHANOL 70% (V/V)

Primary endpoint: Proportion of patients who respond to treatment defined as: a) a ≥3-point reduction in the peak pelvic pain score assessed in the cramping window of Cycle 5 compared to Baseline AND b) no increase in the number of standard pain relief medication taken in the cramping window of Cycle 5 compared to Baseline.

Source: https://euclinicaltrials.eu/ctis-public/view/2023-503688-41-00